EU clinical trial 2024-510826-16-00: A Prospective, Randomized, Double-blind, Parallel-group Study to Compare the Efficacy, Safety, Pharmacokinetics, and Immunogenicity of MB04 and EU-sourced Enbrel® in Patients with Moderate to Severe Rheumatoid Arthritis.
Protocol code: MB04-C-01-23
Sponsor: Mabxience Research S.L. (Pharmaceutical company). Phase: Therapeutic confirmatory (Phase III). Countries: Poland (ended), Hungary (not authorised), Bulgaria (ended), Romania (ended).
Therapeutic area(s): Diseases [C] - Immune System Diseases [C20]
Gender: Female, Male. Age: 18-64 years, 65+ years. Enrolment: 548.
Status: Ended. Start date (EU): 2025-04-07. End date (EU): 2026-02-20. End date: 2026-02-23. Decision date: 2024-08-30. Results received: No. Last updated: 2025-12-17.
Decision dates by country: BG: 2024-09-02, HU: 2024-08-30, RO: 2024-09-02, PL: 2024-08-30

Condition(s): Rheumatoid Arthritis
Product: Enbrel 50 mg solution for injection in pre-filled syringe, Enbrel 50 mg solution for injection in pre-filled syringe

Primary endpoint: ACR20 response rate at Week 24 (proportion of patients achieving ACR20 response at Week 24).
Endpoint(s): ACR20 response rate at Weeks 4, 8, and 12 (for treatment onset evaluation) and Week 36 of dosing (for effect maintenance evaluation)., American College of Rheumatology 50% response criteria (ACR50) response rate at Weeks 4, 8, 12, 24, and 36 of dosing., American College of Rheumatology 70% response criteria (ACR70) response rate at Weeks 4, 8, 12, 24, and 36 of dosing., Changes over time in the disease activity score at 28 joints (DAS28) measured at Weeks 4, 8, 12, 24, and 36., Numeric index of the ACR response (ACR-N) at Week 24., Area under the curve (AUC) of the ACR-N from first administration up to Week 24., AUC of the change in DAS28 from first administration up to Week 24., Classification of European League Against Rheumatism (EULAR) response from first administration up to Week 24.

Source: https://euclinicaltrials.eu/ctis-public/view/2024-510826-16-00